EU clinical trial 2023-506083-13-00: Randomised, double-blind, placebo-controlled and parallel group trial to investigate the effects of one dose (up-titration to a fixed dose regimen) of oral BI 685509 on portal hypertension after 8 weeks treatment in patients with clinically significant portal hypertension (CSPH) in decompensated cirrhosis after their first decompensation event, who are stabilized CTP 5-7
Protocol code: 1366-0055
Sponsor: Boehringer Ingelheim International GmbH, Boehringer Ingelheim Espana S.A., Boehringer Ingelheim RCV GmbH & Co. KG (Pharmaceutical company). Phase: Therapeutic exploratory (Phase II). Countries: Spain (ended), Romania (ended), Germany (ended), France (ended), Austria (ended).
Therapeutic area(s): Diseases [C] - Cardiovascular Diseases [C14]
Gender: Female, Male. Age: 18-64 years, 65+ years. Enrolment: 22.
Status: Ended. Start date (EU): 2024-02-16. End date (EU): 2024-05-02. End date: 2024-05-30. Decision date: 2023-11-22. Results received: Yes. Last updated: 2024-03-04.
Decision dates by country: FR: 2023-11-24, DE: 2023-11-22, ES: 2023-12-01, RO: 2023-11-27, AT: 2023-11-30

Condition(s): clinically significant portal hypertension (CSPH) in decompensated cirrhosis due to non-cholestatic liver disease
Product: BI 685509, Placebo matching BI 685509 PRD9566383, Placebo matching BI 685509 PRD9566375, BI 685509, BI 685509, Placebo matching BI 685509 PRD9566374

Primary endpoint: Percentage change in HVPG from baseline (measured in mmHg) after 8 weeks of treatment
Endpoint(s): Occurrence of a response, which is defined as >10% reduction from baseline HVPG (measured in mmHg) after 8 weeks of treatment, Occurrence of further decompensation events (i.e. ascites, VH, and / or overt HE) during the 8-week treatment period, Occurrence of CTCAE grade 3 (or higher) hypotension or syncope based on Investigator judgement, during the 8-week treatment period, Occurrence of discontinuation due to hypotension or syncope during the 8-week treatment period

Source: https://euclinicaltrials.eu/ctis-public/view/2023-506083-13-00